EU clinical trial 2025-522006-21-00: Feasibility clinical trial of the sequential combination of AloCelyvir and activated tumor-infiltrating lymphocytes (TILs) for the treatment of children and young adults with advanced neuroblastoma
Protocol code: ACTIVE
Sponsor: Fundacion Para La Investigacion Biomedica Del Hospital Universitario La Princesa (Laboratory/Research/Testing facility). Phase: Human Pharmacology (Phase I)- First administration to humans. Countries: Spain (not authorised).
Therapeutic area(s): Diseases [C] - Neoplasms [C04]; Diseases [C] - Nervous System Diseases [C10]
Gender: Female, Male. Age: 0-17 years, 18-64 years. Enrolment: 15.
Status: Not authorised. Decision date: 2026-08-03. Results received: No. Last updated: 2026-08-03.

Condition(s): High-risk relapsed/refractory (R/R) neuroblastoma (NB).
Product: Autologous tumor-infiltrating T lymphocytes, ex vivo expanded with interleukin-7, interleukin-15 and interleukin-21, AloCelyvir

Primary endpoint: The primary endpoint is Dose-Limiting Toxicity (DLT) of the sequential combination of AloCelyvir plus TILs.
Endpoint(s): Nature and frequency of adverse events (AEs), serious adverse events (SAEs), abnormalities in laboratory test results, vital sign measurements, and physical examination findings, graded, when applicable, according to NCI-CTCAE version 5.0., Response rate (complete and partial)., Clinical benefit rate (complete response, partial response, minor response, and stable disease)., Time from enrollment to preparation and administration of AloCelyvir., Time from enrollment to preparation and administration of TILs., Progression-free survival., Overall survival.

Source: https://euclinicaltrials.eu/ctis-public/view/2025-522006-21-00